EU clinical trial 2023-505420-62-00: For patients with active multiple sclerosis, impact of annual versus semi-annual infusions of ocrelizumab after 2 years of initial treatment on the absence of radiological disease activity at 2 years: a multicentre randomised controlled non-inferiority trial
Protocol code: WINDOCRE
Sponsor: Hopital Fondation Adolphe De Rothschild (Hospital/Clinic/Other health care facility). Phase: Therapeutic confirmatory (Phase III). Countries: France (ongoing, recruiting).
Therapeutic area(s): Diseases [C] - Nervous System Diseases [C10]; Diseases [C] - Immune System Diseases [C20]
Gender: Female, Male. Age: 18-64 years, 65+ years. Enrolment: 244.
Status: Ongoing, recruiting. Start date (EU): 2023-11-09. Decision date: 2023-07-31. Results received: No. Last updated: 2026-04-07.

Condition(s): Multiple sclerosis
Product: Ocrevus 300 mg concentrate for solution for infusion

Primary endpoint: Percentage of patients with no new or enlarged T2 lesion >3mm on cerebro-medullary MRI at 24 months compared to inclusion MRI
Endpoint(s): Relapse defined as the onset or worsening of symptoms, in the absence of fever, responsible for an increase of at least 0.5 points in the oberall EDSS score, or of 2 points in at least one functional systems of the EDSS, excluding sphincter and mental/cerebral scores, Disability progression defined as an increase of >20% in Multpile Sclerosis Functional Composite (MSFC) score between inclusion and M24. Disability progression defined by an on-study increase in EDSS score of at least 1 point from baseline if EDSS at baseline was <6, or an increase of at least 0.5 points if EDSS at baseline was equal to 6, Percentage of NEDA 3 patients at M24: NEDA 3 (No Evidence of disease activity) corresponds to the absence of radiological activity and clinical activity : absence of relapses and disability progression, Percentage of patients with at least 3 new T2 lesions on cerebro-medullary MRI at 24 months compared to the inclusion MRI, Number of new T2 lesions on cerebral-medullary MRI at 24 months compared to inclusion MRI, Percentage of patients with no new or enlarged T2 lesion >3mm on cerebro-medullary MRI at 12 months compared to inclusion MRI, Hypogammaglobulinemia defined as a value less than 6g/L, Evolution of the gamma globulin level in plasma protein eletrophoresis between inclusion and M24, Evolution of IgG assays between inclusion and M24., Evolution of IgM assays between inclusion and M24., Evolution of IgA assays between inclusion and M24., Evolution of CD19 lymphocyte counts between inclusion and M24, Incidence of infectious events requiring treatment, Incidence of cancer

Source: https://euclinicaltrials.eu/ctis-public/view/2023-505420-62-00